EU clinical trial 2024-513619-28-00: Study of XmAb 819 in Subjects With Advanced Clear Cell Renal Cell Carcinoma
Protocol code: XmAb819-01
Sponsor: Xencor Inc. (Pharmaceutical company). Phase: Human Pharmacology (Phase I)- First administration to humans. Countries: Belgium (ongoing, recruiting), France (ongoing, recruiting), Spain (ongoing, recruiting).
Therapeutic area(s): Diseases [C] - Neoplasms [C04]
Gender: Female, Male. Age: 18-64 years, 65+ years. Enrolment: 48.
Status: Ongoing, recruiting. Start date (EU): 2025-12-11. Decision date: 2024-12-18. Results received: No. Last updated: 2026-08-07.
Decision dates by country: BE: 2024-12-18, ES: 2024-12-20, FR: 2024-12-31

Condition(s): Clear Cell Renal Cell Carcinoma

Source: https://euclinicaltrials.eu/ctis-public/view/2024-513619-28-00